EU clinical trial 2023-510025-14-00: A phase Ib, open-label, ascending dose study with step-up doses to assess safety, tolerability, and pharmacokinetics of PIT565 in participants with systemic lupus erythematosus (SLE)
Protocol code: CPIT565B12101
Sponsor: Novartis Pharma AG (Pharmaceutical company). Phase: Human Pharmacology (Phase I)- Other. Countries: Bulgaria (ended), Germany (temporarily halted), Netherlands (temporarily halted), Spain (temporarily halted), Hungary (temporarily halted).
Therapeutic area(s): Diseases [C] - Immune System Diseases [C20]
Gender: Female, Male. Age: 18-64 years, 65+ years. Enrolment: 32.
Start date (EU): 2024-10-08. Decision date: 2024-09-09. Results received: No. Last updated: 2026-04-24.
Decision dates by country: BG: 2024-09-16, HU: 2025-08-22, ES: 2024-09-19, NL: 2024-09-12, DE: 2024-09-12

Condition(s): Systemic Lupus Erythematosus

Source: https://euclinicaltrials.eu/ctis-public/view/2023-510025-14-00